EU clinical trial 2024-516793-30-00: Study of post-total thyroidectomy hypocalcemia after preoperative cholecalciferol supplementation.
Protocol code: CHRD2115
Sponsor: Hopital NOVO (Hospital/Clinic/Other health care facility). Phase: Therapeutic confirmatory (Phase III). Countries: France (ended).
Therapeutic area(s): Not possible to specify
Gender: Female, Male. Age: 18-64 years, 65+ years. Enrolment: 200.
Status: Ended. Start date (EU): 2024-10-16. End date (EU): 2026-01-30. Decision date: 2024-10-16. Results received: No. Last updated: 2025-07-25.

Condition(s): Thyroidectomy is a common operation. Transient postoperative hypocalcemia is the main complication, resulting in clinical discomfort for patients, longer hospital stays and increased perioperative cost. Cholecalciferol is used to supplement vitamin D deficiency. We suppose that systematic pre-operative supplementation with cholecalciferol would allow a faster and more appropriate response to post-operative hypocalcemia
Product: UVEDOSE 100 000 UI, solution buvable en ampoule

Primary endpoint: Measure of the occurrence of serum and / or clinical hypocalcemia Serum hypocalcemia is defined by a level of calcemia, corrected for albuminemia, of less than 2.00 mmol / L. Clinical hypocalcemia is defined by the appearance of one of the following signs: sign of Chvostek, sign of Trousseau, paresthesias of the extremities and perioral between surgery and D15
Endpoint(s): Duration of initial hospitalization (number of hospital days), collect of adverse events and number of readmissions, Measure of severity of hypocalcemia defined by a calcemia corrected for albuminemia of less than 1.90 mmol / L and / or the use of calcium gluconate IV in the first 15 post-operative days., Measure of duration of hypocalcemia's symptoms in the first 15 days postoperative, Vitamin D deficiency will be measured by comparing the initial value of 25OHD at the inclusion visit to the value of 25OHD of the day of the operation (D0=H0), Collect of the number of adverse events and serum calcium levels for each participant, Collect of the definitive hypocalcemia's numbers in each group, Parathyroid activity will be evaluated in both group by measuring parathormone (PTH). Hypoparathyroidism being defined by PTH < 15 ng / L.

Source: https://euclinicaltrials.eu/ctis-public/view/2024-516793-30-00